EU clinical trial 2024-515749-40-00: A pivotal Phase III, open-label, randomized, controlled multi-center study of the efficacy of L19IL2/L19TNF neoadjuvant intratumoral treatment followed by surgery versus surgery alone in clinical stage III B/C melanoma patients
Protocol code: PH-L19IL2TNF-02/15
Sponsor: Philogen S.p.A. (Pharmaceutical company). Phase: Therapeutic confirmatory (Phase III). Countries: Poland (ongoing, recruitment ended), Italy (ongoing, recruitment ended), France (ongoing, recruitment ended), Germany (ongoing, recruitment ended).
Therapeutic area(s): Diseases [C] - Neoplasms [C04]
Gender: Female, Male. Age: 18-64 years, 65+ years. Enrolment: 256.
Status: Ongoing, recruitment ended. Start date (EU): 2016-02-25. Decision date: 2024-07-31. Results received: No. Last updated: 2026-04-15.
Decision dates by country: DE: 2024-07-31, IT: 2024-08-12, FR: 2024-08-05, PL: 2024-08-29

Condition(s): Malignant melanoma of the skin in patients with locally advanced and fully resectable melanoma with/without prior therapy and presence of injectable cutaneous and/or subcutaneous or nodal lesions
Product: Darleukin, Fibromun

Primary endpoint: Recurrence-free survival (RFS) in the treatment arm (L19IL2/L19TNF plus surgery; Arm 1) versus control arm (Arm 2)
Endpoint(s): Overall survival (OS) in the treatment arm (L19IL2/L19TNF plus surgery; Arm 1) versus control arm (surgery; Arm 2), Local recurrence-free survival (LRFS) and distant metastasis-free survival (DMFS) in the treatment arm (L19IL2/L19TNF plus surgery - Arm 1) versus control arm (Arm 2), Proportion of patients with pathological responses (defined as the proportion of patients with a pathological CR, pathological near-CR, or pathological PR), Safety of intratumoral administration of L19IL2/L19TNF, Biomarker studies (both arms): immunophenotypic characterization of PBMCs for changes in absolute counts and relative percentages of lymphocytic subpopulations (e.g., Tregs, MDSCs etc.) over time (only for patients recruited in German centers; the data will be collected for at least 50 patients). Study of blood biomarkers, Assessment of the formation of human anti-fusion protein antibodies (HAFA) against L19IL2 and L19TNF

Source: https://euclinicaltrials.eu/ctis-public/view/2024-515749-40-00